EU clinical trial 2024-517539-38-00: Phase 1 first-in-human, single and multiple dosing study of FB301 in healthy female subjects
Protocol code: FRB-002
Sponsor: Freya Biosciences ApS (Pharmaceutical company). Phase: Human Pharmacology (Phase I)- First administration to humans. Countries: Germany (ended).
Therapeutic area(s): Diseases [C] - Female Urogenital Diseases and Pregnancy Complications [C13]
Gender: Female. Age: 18-64 years. Enrolment: 89.
Status: Ended. Start date (EU): 2025-02-13. End date (EU): 2026-01-06. Decision date: 2025-02-06. Results received: No. Last updated: 2025-04-29.
Decision dates by country: DE: 2025-04-29

Condition(s): Women infertility

Source: https://euclinicaltrials.eu/ctis-public/view/2024-517539-38-00